EU clinical trial 2023-508606-26-00: A Phase 3 Randomized, Placebo-controlled Double-blind Study of JNJ-56021927 in Combination with Abiraterone Acetate and Prednisone Versus Abiraterone Acetate and Prednisone in Subjects with Chemotherapy-naïve Metastatic Castration-resistant Prostate Cancer (mCRPC)
Protocol code: 56021927PCR3001
Sponsor: Janssen Cilag International (Pharmaceutical company). Phase: Therapeutic confirmatory (Phase III). Countries: Netherlands (ended), Spain (ongoing, recruitment ended), Germany (ongoing, recruitment ended).
Therapeutic area(s): Diseases [C] - Neoplasms [C04]
Gender: Male. Age: 18-64 years, 65+ years. Enrolment: 5.
Start date (EU): 2015-04-23. Decision date: 2024-02-01. Results received: No. Last updated: 2026-07-09.
Decision dates by country: ES: 2024-02-05, NL: 2024-02-01, DE: 2024-02-05

Condition(s): Metastatic castration-resistant prostate cancer (mCRPC)
Product: ZYTIGA 250 mg tablets, JNJ-56021927, placebo to match JNJ-56021927/Apalutamide, Prednison acis 5 mg, Tabletten

Primary endpoint: The primary endpoint is radiographic progression-free survival (rPFS).
Endpoint(s): Overall survival (OS) is defined as the time from date of randomization to date of death from any cause., Time to chronic opioid use (oral opioid use for ≥3 weeks; parenteral opioid use for ≥7 days) is defined as the time from date of randomization to the first date of opioid use, Time to initiation of cytotoxic chemotherapy is defined as the time from date of randomization to the date of initiation of cytotoxic chemotherapy, Time to pain progression defined as the time from date of randomization to the first date a subject experience an increase by 2 points from baseline in the BPI-SF worst pain intensity item 3 observed at 2 consecutive evaluations ≥4 weeks apart or initiation of chronic opioids, whichever occurs first

Source: https://euclinicaltrials.eu/ctis-public/view/2023-508606-26-00